EU clinical trial 2024-515344-23-00: PHASE II study evaluating the benefit of Sequential Treatment With GEMBRAX and Then FOLFIRINOX Followed by Stereotactic MRI-guided Radiotherapy in Patients With Locally Advanced Pancreatic Cancer
Protocol code: PROICM 2020-04 GAB
Sponsor: Institut Regional Du Cancer De Montpellier (Hospital/Clinic/Other health care facility). Phase: Therapeutic exploratory (Phase II). Countries: France (ongoing, recruiting).
Therapeutic area(s): Diseases [C] - Neoplasms [C04]; Diseases [C] - Digestive System Diseases [C06]
Gender: Female, Male. Age: 18-64 years, 65+ years. Enrolment: 103.
Status: Ongoing, recruiting. Start date (EU): 2021-06-17. Decision date: 2024-08-12. Results received: No. Last updated: 2025-03-24.

Condition(s): local advenced pancreatic adenocarcinoma
Product: Abraxane 5 mg/ml powder for dispersion for infusion., IRINOTECAN VIATRIS 20 mg/ml, solution à diluer pour perfusion, FLUOROURACILE ACCORD 50 mg/ml, solution à diluer pour perfusion, Gemcitabine Accord 100 mg/ml koncentratas infuziniam tirpalui, OXALIPLATINE ARROW LAB 5 mg/mL, solution à diluer pour perfusion, FLUOROURACILE ACCORD 50 mg/ml, solution à diluer pour perfusion, LEVOFOLINATE DE CALCIUM ZENTIVA 25 mg/2,5ml, solution injectable (IM/IV)

Primary endpoint: 1: Non-progression rate at 4 months (SEQ1 success rate) according to RECIST 1.1 criteria 2: Rate of RT-related acute digestive non-toxicity within 90d of grade ≥3 assessed by NCI CTC AE v5.0 classification
Endpoint(s): Tolerance of chemotherapy sequence assessed by NCI CTC AE v5.0 classification, Tolerance (acute and delayed toxicities) of radiotherapy sequence assessed by NCI CTC AE v5.0 classification, Collection of dosimetric results obtained in terms of dose/volume on predictive dosimetry (PTV coverage by prescription dose on totalized dosimetry, dose received at GTV....), Collection and summation of dosimetric results obtained in terms of dose/volume for adaptive radiotherapy sessions, and comparison with predictive dosimetry., Correlation of dose to organs at risk (duodenum, small intestine, stomach, colon) with the occurrence of digestive toxicities (predictive and adaptive dosimetry), Correlation of PTV coverage and GTV dose with progression-free survival and overall survival (predictive and adaptive dosimetry), Progression-free survival defined as time from radiotherapy start date to date of 1st documented progression or date of death from any cause. - Overall survival defined as time from radiotherapy start date to date of death from any cause., Overall survival defined as time from radiotherapy start date to date of death from any cause., Local disease control rate defined as the proportion of patients without local progression, with time to local progression defined as the time from radiotherapy start date to the date of documented local progression. Patients without local progression will be censored at the date of last news, Progression-free survival defined as time from inclusion to date of 1st documented progression or date of death from any cause., Overall survival defined as time from date of inclusion to date of death from any cause., Tolerance of overall treatment assessed by NCI CTC AE v5.0 classification., Resection rate defined as the percentage of patients operated on up to 6 months post-radiotherapy., R0 resection rate, Histological response rate* according to CAP score30, 31, 32, Assess the prognostic impact of CA 19.9 evolution on survival, Evolution of Quality of Life scores assessed by the EORTC QLQ-C30 and PAN 26 questionnaires.

Source: https://euclinicaltrials.eu/ctis-public/view/2024-515344-23-00